EU clinical trial 2024-513866-20-00: Nivolumab plus Ipilimumab plus two cycles of platinum-based chemotherapy as first line treatment for stage IV/recurrent non-small cell lung cancer (NSCLC) patients with synchronous Brain metastases_NIVIPI-Brain
Protocol code: GECP 21/02
Sponsor: Fundacion GECP (Patient organisation/association). Phase: Therapeutic exploratory (Phase II). Countries: Spain (ongoing, recruitment ended).
Therapeutic area(s): Diseases [C] - Neoplasms [C04]
Gender: Female, Male. Age: 18-64 years, 65+ years. Enrolment: 71.
Status: Ongoing, recruitment ended. Start date (EU): 2021-11-18. Decision date: 2024-05-24. Results received: No. Last updated: 2025-11-21.

Condition(s): Non-small cell lung cancer with brain metastasis
Product: YERVOY 5 mg/ml concentrate for solution for infusion, OPDIVO 10 mg/mL concentrate for solution for infusion.

Primary endpoint: The primary objective of this trial is to determine the rate of intracranial clinical benefit, defined as the percentage of patients who had lack of radiological or clinical progression for at least 6 months according to RANO-BM assessment criteria.
Endpoint(s): 1. To evaluate the efficacy of Nivolumab + Ipilimumab + 2 cycles of chemotherapy in patients with NSCLC and synchronous brain metastases in terms of objective response rate (ORR), duration of response (DOR), progression-free survival (PFS) and overall survival (OS)., 2, To evaluate the efficacy of Nivolumab + Ipilimumab + 2 cycles of chemotherapy in patients with NSCLC and synchronous brain metastases in terms of the investigator assessed bicompartimental PFS defined as systemic PFS (excluding CNS) as per RECIST version 1.1 and PFS in the CNS as per RANO-BM criteria, 3, To evaluate the safety of Nivolumab + Ipilimumab + 2 cycles of chemotherapy in patients with NSCLC and synchronous brain metastases., 4, Overall survival (OS) at 12, 18 and 24 defined as the time from enrollment to death from any cause at this landmark timepoints, 5, To determine the quality of life (QoL)

Source: https://euclinicaltrials.eu/ctis-public/view/2024-513866-20-00